EU clinical trial 2024-518498-32-01: Protecting late-moderate preterm infants from respiratory tract infections and wheeze in their first year of life by using bacterial lysates
Sponsor: Sint Franciscus Vlietland Groep Stichting (Hospital/Clinic/Other health care facility). Phase: Therapeutic confirmatory (Phase III). Countries: Netherlands (ongoing, recruiting).
Therapeutic area(s): Diseases [C] - Bacterial Infections and Mycoses [C01]; Diseases [C] - Respiratory Tract Diseases [C08]; Diseases [C] - Virus Diseases [C02]
Gender: Female, Male. Age: 0-17 years. Enrolment: 500.
Status: Ongoing, recruiting. Start date (EU): 2024-12-05. Decision date: 2024-12-05. Results received: No. Last updated: 2026-07-20.

Condition(s): Lower respiratory tract infections and wheezing in moderate-late premature infants
Product: BRONCHO-VAXOM Kinderen, capsules, hard

Primary endpoint: Protea-1: Total number of physician diagnosed lower RTI and wheezing episodes in the first year of life., Protea-2: The time to the first lower respiratory episode after 12 months of age.
Endpoint(s): time to first lower RTI or wheezing episode in the first year of life, total number of RTI in the first and second year of life, total number of wheezing episodes in the first and second year of life, distribution of viruses during lower RTI/wheezing, medication use (bronchodilators, corticosteroids, antibiotics), lung function as measured by expiratory variability index, quality of life, (serious) adverse events (respiratory episodes are not regarded as an (S)AE since they comprise primary and secondary outcomes), serum specific IgE (allergen sensitization) at 12 months, infant vaccination titers at 12 months, costs- and cost-effectiveness

Source: https://euclinicaltrials.eu/ctis-public/view/2024-518498-32-01